EU clinical trial 2025-520808-10-00: Role of inhaled nitric oxide on right ventricular function and pulmonary vascular mechanics following cardiac surgery
Sponsor: Fundacion Para La Investigacion Biomedica Del Hospital Universitario La Princesa (Laboratory/Research/Testing facility). Phase: Therapeutic confirmatory (Phase III). Countries: Spain (authorised, recruitment pending).
Therapeutic area(s): Analytical, Diagnostic and Therapeutic Techniques and Equipment [E] - Therapeutics [E02]
Gender: Female, Male. Age: 18-64 years, 65+ years. Enrolment: 50.
Status: Authorised, recruitment pending. Decision date: 2025-01-24. Results received: No. Last updated: 2025-01-24.

Condition(s): Patients in the immediate cardiac surgery post-operative period
Product: VasoKINOX 800 ppm mol/mol, gas comprimido medicinal

Primary endpoint: Parameters of right ventricular function
Endpoint(s): Results of the electrical impedance tomography (EIT): regional distribution of ventilation and perfusion and EIT pulsatility

Source: https://euclinicaltrials.eu/ctis-public/view/2025-520808-10-00